EU clinical trial 2023-507790-18-00: Encapsulated Fecal Microbiota Transfer to Treat Immune Activation in Patients with Cirrhosis and Ascites (TransImmune) – A randomized, double-blind, placebo-controlled phase IIa clinical pilot study
Protocol code: 22-377
Sponsor: Universitaetsklinikum Aachen AöR (Hospital/Clinic/Other health care facility). Phase: Therapeutic exploratory (Phase II). Countries: Germany (ongoing, recruiting).
Therapeutic area(s): Diseases [C] - Digestive System Diseases [C06]
Gender: Female, Male. Age: 18-64 years, 65+ years. Enrolment: 24.
Status: Ongoing, recruiting. Start date (EU): 2025-08-01. Decision date: 2024-08-08. Results received: No. Last updated: 2026-07-22.

Condition(s): cirrhosis and ascites
Product: INTESTIFIX 001, Intestifix 001 placebo

Primary endpoint: The occurrence of serious adverse events (SAE) up to the end of the study (EOS)., The occurrence and its severity of treatment-emergent adverse events (TEAE) and adverse events (AE).
Endpoint(s): Systemic inflammation: Differences in white blood cell count, C-reactive protein, procalcitonin, and IL-6 between baseline (day 0) and V3 (day 7±2), V4 (day 28±3), and EOS (day 90+14)., Gut inflammation: Differences in faecal calprotectin between baseline (day 0) and V3 (day 7±2), V4 (day 28±3), and EOS (day 90+14)., Organ dysfunction: Differences in Child-Pugh score, Model of End Stage Liver Disease (MELD) score, Chronic Liver Failure-Sequential Organ Failure Assessment (CLIF-SOFA / CLIF-C OF) score between baseline (day 0) and V3 (day 7±2), V4 (day 28±3), and EOS (day 90+14)., Quality of life: Differences in EQ-5D-5L and CLDQ score between baseline (day 0) and EOS (day 90+14)., Antibiotic-free days: Number of days without antibiotic use (except for oral use of norfloxacin or rifaximin) between baseline (day 0) and EOS (day 90+14).

Source: https://euclinicaltrials.eu/ctis-public/view/2023-507790-18-00